EU clinical trial 2026-525566-21-00: A phase IIa, single-arm, single-center, open label, proof-of-concept trial evaluating increased frequency dosing of VCN-01 (zabilugene almadenorepvec) in combination with nab-Paclitaxel/Gemcitabine (GnP) in Patients with Newly-Diagnosed Metastatic Pancreatic Cancer (VIRAGE2)
Protocol code: P-VCNA-004
Sponsor: Theriva Biologics S.L. (Pharmaceutical company). Phase: Therapeutic exploratory (Phase II). Countries: Spain (ongoing, recruiting).
Therapeutic area(s): Diseases [C] - Neoplasms [C04]
Gender: Female, Male. Age: 18-64 years, 65+ years. Enrolment: 6.
Status: Ongoing, recruiting. Start date (EU): 2026-07-20. Decision date: 2026-06-30. Results received: No. Last updated: 2026-06-30.

Condition(s): metastatic pancreatic adecarcinoma
Product: VCN-01

Primary endpoint: • Safety and tolerability of the administration regimen of VCN-01 administered every 56 days, with three planned doses, combined with SoC GnP cycles., • Pharmacodynamics of VCN-01 following intravenous administration and characterization of the pharmacokinetic profile across the three planned doses.
Endpoint(s): • Proportion of participants who have a partial or complete response confirmed by RECIST 1.1 to the combination therapy (Objective response rate (ORR))., • Progression Free Survival (PFS), defined as the time from the first VCN-01 dose until radiologically confirmed progressive disease (according to RECIST version 1.1) or death by any cause., • Duration of response (DoR) defined as the time from the first partial response or complete response until radiologically confirmed progressive disease (according to RECIST version 1.1) or death by any cause., • Landmark one-year and 18-months Overall survival (OS), • Disease control rate (DCR), defined as the proportion of participants whose best response is either stable disease or partial response or complete response (according to RECIST version 1.1)., • Changes in serum levels of neutralizing anti-adenovirus antibodies (Anti-Ad-NAbs), • Changes in serum levels of tumor marker CA 19-9.

Source: https://euclinicaltrials.eu/ctis-public/view/2026-525566-21-00